EU clinical trial 2023-508920-37-00: Targeting triple negative BREAst cancer metabolism with a combination of chemotherapy and a diet mimicking FASTing plus/minus metformin in the preoperative setting: the BREAKFAST trial
Protocol code: BREAKFAST
Sponsor: Fondazione IRCCS Istituto Nazionale Dei Tumori (Hospital/Clinic/Other health care facility). Phase: Therapeutic exploratory (Phase II). Countries: Italy (ongoing, recruitment ended).
Therapeutic area(s): Diseases [C] - Neoplasms [C04]
Gender: Female. Age: 18-64 years, 65+ years. Enrolment: 32.
Status: Ongoing, recruitment ended. Start date (EU): 2020-05-20. Decision date: 2023-11-21. Results received: No. Last updated: 2023-11-21.

Condition(s): Triple negative breast cancer
Product: METFORAL 850 mg compresse rivestite con film

Primary endpoint: Pathologic complete response (pCR), as defined as the absence of residual tumor cells in both breast tissue and axillary lymph nodes.
Endpoint(s): Relapse free survival (RFS), as defined as the time from surgery to tumor recurrence, either local or distant, Distant metastasis free survival (DMFS), as defined as the time from surgery to the occurrence of distant metastases, Overall Survival (OS), as defined as the time from randomization to the date of death. Patients alive at time of data cut-off and analysis will be censored at their last contact date, Metabolic biomarkers (e.g. plasma glucose, insulin, insulin-like growth factor 1 (IGF-1) levels and whole blood and plasma lipid profile, fecal microbiota) assessed at baseline and at each chemotherapy cycle, Role of DNA repair, mTORC 1, PP2A, autophagy and Beclin 1 pathways in the efficacy of the experimental treatments, defined as the rate of pCRs, Dose-intensity, that is the dose of effective drug administrated per unit of time (e.g. mg/m2/week), Percentage of patients with drug dose and/or time modifications, Percentage of patients with experimental dietary regimen modifications, Percentage of premature withdrawals, Incidence, nature, severity and seriousness of AEs, according of NCI-CTCAE, version 5.0, Maximum toxicity grade experienced by each patient for each specific toxicity, Percentage of patients experiencing grade 3-4 toxicity for each specific toxicity, Patients with at least a SAE

Source: https://euclinicaltrials.eu/ctis-public/view/2023-508920-37-00